EU clinical trial 2024-517200-10-00: FoRT 05- BEAT Phase II randomized trial comparing atezolizumab versus atezolizumab plus bevacizumab as first-line treatment in PD-L1 high advanced non-small-cell lung cancer patients
Sponsor: Fondazione Ricerca Traslazionale (Laboratory/Research/Testing facility). Phase: Therapeutic exploratory (Phase II). Countries: Italy (ongoing, recruiting).
Therapeutic area(s): Diseases [C] - Neoplasms [C04]
Gender: Female, Male. Age: 18-64 years, 65+ years. Enrolment: 130.
Status: Ongoing, recruiting. Start date (EU): 2020-01-31. Decision date: 2024-11-26. Results received: No. Last updated: 2025-10-23.
Decision dates by country: IT: 2024-11-29

Condition(s): Advanced non-small-cell lung cancer
Product: Avastin 25 mg/ml concentrate for solution for infusion., Tecentriq 1 200 mg concentrate for solution for infusion

Primary endpoint: Overall Survival (OS) in patients treated with atezolizumab alone versus atezolizumab-bevacizumab combination

Source: https://euclinicaltrials.eu/ctis-public/view/2024-517200-10-00